EU clinical trial 2023-508601-24-00: A Phase 1/2 Study of REGN7257 (Anti-Interleukin 2 Receptor Subunit Gamma [IL2RG] Monoclonal Antibody) in Patients with Severe Aplastic Anemia that is Refractory to or Relapsed on Immunosuppressive Therapy
Protocol code: R7257-RAA-1947
Sponsor: Regeneron Pharmaceuticals Inc. (Pharmaceutical company). Phase: Phase I and Phase II (Integrated)- First administration to humans. Countries: France (ended).
Therapeutic area(s): Diseases [C] - Nutritional and Metabolic Diseases [C18]
Gender: Female, Male. Age: 18-64 years, 65+ years. Enrolment: 14.
Status: Ended. Start date (EU): 2021-09-13. End date (EU): 2025-06-16. End date: 2025-06-17. Decision date: 2024-06-14. Results received: Yes. Last updated: 2024-10-24.

Condition(s): Severe aplastic anemia (SAA)
Product: REGN7257

Primary endpoint: Part A: Incidence of adverse events (AEs), incidence of serious adverse events (SAEs), and incidence and severity of treatment-emergent adverse events (TEAEs);, Part B: Incidence of serious adverse events (SAEs), incidence and severity of treatment-emergent adverse events (TEAEs);, Part B: Overall response rate (ORR);
Endpoint(s): Overall response rate (ORR); Parts A & B, Complete response (CR); Parts A and B, Partial response (PR); Parts A and B, Time to best response; Part A, Time to best response; Part B, Time to first response; Part A, Time to first response; Part B, Any clinical response; Part A, Any clinical response; Part B, Platelet transfusions per month over time; Part A, Platelet transfusions per month over time; Part B, Red blood cell transfusions per month over time; Part A, Red blood cell transfusions per month over time; Part B, Changes in lymphocyte cell counts; Part A, Changes in lymphocyte cell counts; Part B, Changes in neutrophil cell counts; Part A, Changes in neutrophil cell counts; Part B, Changes in hemoglobin cell counts; Part A, Changes in hemoglobin cell counts; Part B, Changes in reticulocyte cell counts; Part A, Changes in reticulocyte cell counts; Part B, Changes in platelet cell counts; Part A, Changes in platelet cell counts; Part B, Changes in the whole blood immune cell subsets (T cells); Part A, Changes in the whole blood immune cell subsets (T cells); Part B, Changes in the whole blood immune cell subsets (B cells); Part A, Changes in the whole blood immune cell subsets (B cells); Part B, Changes in the whole blood immune cell subsets [Natural killer (NK) cells]; Part A, Changes in the whole blood immune cell subsets (NK cells); Part B, Drug concentrations in serum over time; Part A, Drug concentrations in serum over time; Part B, Incidence of treatment-emergent anti-drug antibody (ADA) over time; Part A, Incidence of treatment-emergent ADA over time; Part B

Source: https://euclinicaltrials.eu/ctis-public/view/2023-508601-24-00